EU clinical trial 2024-514146-37-00: Open-label, randomized, two-treatment, two-period, two-sequence, cross-over, single dose, bioequivalence study comparing ISOPRINOSINE® FORTE 100 mg/mL Syrup to ISOPRINOSINE® 500 mg tablets in healthy male and female subjects under fasting conditions.
Protocol code: EWO-ISO-2024/BE2
Sponsor: Ewopharma AG (Pharmaceutical company). Phase: Human Pharmacology (Phase I)- Bioequivalence Study. Countries: Czechia (ended).
Therapeutic area(s): Diseases [C] - Virus Diseases [C02]
Gender: Female, Male. Age: 18-64 years. Enrolment: 36.
Status: Ended. Start date (EU): 2024-10-24. End date (EU): 2024-11-21. Decision date: 2024-09-06. Results received: No. Last updated: 2024-09-06.

Condition(s): not applicable (submitted trial is a bioequivalence study)

Source: https://euclinicaltrials.eu/ctis-public/view/2024-514146-37-00